EU clinical trial 2024-519575-26-00: A phase 2, multicentre, open-label, single arm study to evaluate the effectiveness and safety of rezafungin (as acetate) in the treatment of chronic pulmonary aspergillosis (CPA) in patients with limited treatment options
Protocol code: MR907-2502
Sponsor: Mundipharma Research Limited (Pharmaceutical company). Phase: Therapeutic exploratory (Phase II). Countries: Hungary (ended), Belgium (ongoing, recruitment ended), Austria (ongoing, recruitment ended), Germany (ongoing, recruitment ended), Netherlands (ongoing, recruitment ended), Italy (ongoing, recruitment ended), France (ongoing, recruitment ended), Spain (ongoing, recruitment ended).
Therapeutic area(s): Diseases [C] - Bacterial Infections and Mycoses [C01]
Gender: Female, Male. Age: 18-64 years, 65+ years. Enrolment: 31.
Start date (EU): 2025-07-25. Decision date: 2025-07-25. Results received: No. Last updated: 2026-04-24.
Decision dates by country: HU: 2025-07-29, ES: 2025-07-28, DE: 2025-07-28, FR: 2025-07-30, NL: 2025-07-28, IT: 2025-07-28, BE: 2025-07-25, AT: 2025-07-30

Condition(s): Chronic pulmonary aspergillosis (CPA)
Product: REZZAYO 200 mg powder for concentrate for solution for infusion

Primary endpoint: [Clinical 1:] SGRQ - a patient reported outcome questionnaire (improvement, stable or deterioration of quality of life), [Clinical 2:] Weight (weight gain / loss), [Radiological:] CT thoracic scan to assess radiological improvement (CT changes assessed by a central imaging vendor)
Endpoint(s): Change in Aspergillus IgG levels, weight, SGRQ score, Respiratory Symptom Score and EQ-5D-5L score at 3 and 6 months from baseline, Need for antibiotic treatment, change in antibiotic treatment or change in steroid dose, Absence of persistently positive respiratory sample for Aspergillus spp., Change in frequency of echinocandin resistant isolates, Hospitalisations attributed to deterioration in any category, Safety and tolerability of up to 6 months’ treatment; this will be assessed by nature and severity of adverse events (AEs) and serious adverse events (SAEs), physical examinations and laboratory tests, [Exploratory endpoint:] Rezafungin plasma concentrations

Source: https://euclinicaltrials.eu/ctis-public/view/2024-519575-26-00